EU clinical trial 2024-515660-31-00: Phase 2 Study of Preoperative Gemcitabine Plus Cisplatin with Durvalumab (MEDI4736) and Tremelimumab in intrahepatic cholangiocarcinoma (NeoTreme)
Sponsor: Universitaetsklinikum Schleswig-Holstein AöR (Hospital/Clinic/Other health care facility). Phase: Therapeutic exploratory (Phase II). Countries: Germany (ended).
Therapeutic area(s): Diseases [C] - Neoplasms [C04]
Gender: Female, Male. Age: 18-64 years, 65+ years. Enrolment: 31.
Status: Ended. Start date (EU): 2023-06-27. End date (EU): 2026-01-12. Decision date: 2024-10-24. Results received: No. Last updated: 2025-12-18.

Condition(s): intrahepatic cholangiocarcinoma
Product: GEMCITABINE HYDROCHLORIDE, CISPLATIN, IMFINZI 50 mg/mL concentrate for solution for infusion., IMJUDO 20 mg/ml concentrate for solution for infusion.

Primary endpoint: R0/R1-resection rates
Endpoint(s): Pathological response rates, radiological resectability and response, safety and toxicity, 90-day perioperative morbidity, mortality and QoL

Source: https://euclinicaltrials.eu/ctis-public/view/2024-515660-31-00